EU clinical trial 2023-508766-14-00: C5351004 -A Phase 2/3 Randomized, Multicenter Study of Osivelotor Administered Orally to Adult and Adolescent Participants with Sickle Cell Disease
Protocol code: C5351004
Sponsor: Global Blood Therapeutics Inc. (Pharmaceutical company). Phase: Phase II and Phase III (Integrated). Countries: Germany (authorised, recruitment pending), France (not authorised).
Therapeutic area(s): Diseases [C] - Hemic and Lymphatic Diseases [C15]
Gender: Female, Male. Age: 0-17 years, 18-64 years. Enrolment: 20.
Decision date: 2024-07-23. Results received: No. Last updated: 2026-07-13.
Decision dates by country: FR: 2024-07-25, DE: 2024-07-23

Condition(s): Sickle Cell Disease
Product: Placebo tablets for gbt021601 150 mg, Placebo tablets for GBT021601 100 mg, GBT021601, GBT021601, Gbt021601, Placebo tablets for GBT021601 25 mg

Primary endpoint: 1. Part A: Change from baseline in Hb through Week 12., 2. Part B: Co-primary endpoints • Hb response (increase from baseline of > 1 g/dL) at Week 48 (based on average of Hb levels at Week 40 and Week 48). • Annualized rate of VOC through end of Week 48., 3. OLE: • Incidence of Treatment Emergent Adverse Events (TEAEs) • Incidence of serious adverse events (SAEs) • Incidence of AEs leading to discontinuation • Change from baseline in laboratory parameters.
Endpoint(s): 1. Part A: • Hb response at Week 12 (increase from baseline of >1 g/dL). • Change from baseline in hemolysis measures, including indirect bilirubin, absolute and % reticulocytes, and lactate dehydrogenase (LDH) through Week 12. • Incidence of treatment-emergent adverse events (TEAE), changes in laboratory assessments, ECGs, and vital signs., 2. Part A: • Effect on Hb oxygen equilibrium curves (OECs) as measured by p50 through Week 12. • AUC, Cmax, time of maximum concentration (Tmax), blood to plasma (B:P) ratios of these PK parameters (except Tmax) after the first dose. Cmin and B:P ratio after multiple dose administration. • % Hb occupancy through Week 12., 3. Part B: Key Secondary Efficacy Endpoints: • Change from baseline in absolute reticulocyte count at Week 48 • Change from baseline in PROMIS SF Fatigue 13a raw total score at Week 48 among adult participants. • Change from baseline in PROMIS SF Pain Interference 8a raw total score at Week 48 among adult participants., 4. OLE: • Annualized rate of VOC. • Incidence of SCD-related AEs., 5. • Change from baseline in markers of hemolysis (hemoglobin, absolute reticulocyte count, lactate dehydrogenase, indirect bilirubin). • Hb response over time (increase from baseline of >1 g/dL).

Source: https://euclinicaltrials.eu/ctis-public/view/2023-508766-14-00